EU clinical trial 2023-505486-92-00: ENGIC 02 - PRODIGE 86-FOLFIRINOX SBA- Phase II randomized trial evaluating modified FOLFIRINOX and FOLFOX in the treatment of locally advanced or metastatic small bowel adenocarcinoma
Protocol code: PRODIGE 86
Sponsor: Centre Hospitalier Universitaire De Dijon (Hospital/Clinic/Other health care facility). Phase: Therapeutic exploratory (Phase II). Countries: France (ongoing, recruiting), Italy (authorised, recruitment pending).
Therapeutic area(s): Phenomena and Processes [G] - Digestive System and Oral Physiological Phenomena [G10]; Diseases [C] - Digestive System Diseases [C06]
Gender: Female, Male. Age: 18-64 years, 65+ years. Enrolment: 130.
Start date (EU): 2024-02-09. Decision date: 2023-09-29. Results received: No. Last updated: 2026-05-13.
Decision dates by country: IT: 2025-11-27, FR: 2023-09-29

Condition(s): Small bowel adenocarcinoma
Product: CALCIUM LEVOFOLINATE, OXALIPLATIN, FLUOROURACIL, FLUOROURACIL, IRINOTECAN HYDROCHLORIDE TRIHYDRATE, OXALIPLATIN, CALCIUM LEVOFOLINATE, FLUOROURACIL

Primary endpoint: Progression at 8 months
Endpoint(s): Survival, Pregression-free survival

Source: https://euclinicaltrials.eu/ctis-public/view/2023-505486-92-00